EU clinical trial 2024-514500-14-00: A Phase 3, Randomized, Open-label, Multicenter Clinical Study to Evaluate the Safety and Efficacy of MK-1084 in Combination With Subcutaneous Pembrolizumab and Berahyaluronidase alfa (MK-3475A) Versus MK-3475A in Combination With Pemetrexed/Platinum (Carboplatin or Cisplatin) Chemotherapy as First-line Treatment of Participants With KRAS G12C-Mutant, Advanced or Metastatic Nonsquamous NSCLC (KANDLELIT-007)
Protocol code: MK-1084-007
Sponsor: Merck Sharp & Dohme LLC (Pharmaceutical company). Phase: Therapeutic confirmatory (Phase III). Countries: Germany (authorised, recruitment pending), Italy (ongoing, recruiting), France (ongoing, recruiting), Poland (ongoing, recruiting), Spain (ongoing, recruiting), Hungary (ongoing, recruiting), Romania (ongoing, recruiting), Greece (ongoing, recruiting), Austria (ongoing, recruiting), Netherlands (authorised, recruiting), Belgium (ongoing, recruiting).
Therapeutic area(s): Diseases [C] - Neoplasms [C04]
Gender: Female, Male. Age: 18-64 years, 65+ years. Enrolment: 234.
Start date (EU): 2025-12-15. Decision date: 2025-11-27. Results received: No. Last updated: 2026-05-25.
Decision dates by country: AT: 2025-12-01, FR: 2025-12-01, DE: 2025-12-30, GR: 2026-01-19, HU: 2025-11-28, IT: 2026-01-30, RO: 2025-12-02, ES: 2025-11-27, PL: 2025-11-30, NL: 2026-03-12, BE: 2026-02-05

Condition(s): Participants with KRAS G12C-Mutant, Advanced or Metastatic Nonsquamous NSCLC
Product: MK-3475A, PEMETREXED, MK-1084, MK-1084, CISPLATIN, CARBOPLATIN, MK-1084, MK-1084

Primary endpoint: Progression Free Survival (PFS) in Participants with Programmed Death-Ligand 1 (PD-L1) Tumor Proportion Score (TPS) ≥1%
Endpoint(s): PFS in All Participants, Overall Survival (OS) in Participants with PD-L1 TPS ≥1%, OS in All Participants, Overall Response Rate (ORR) in All Participants, ORR in Participants with PD-L1 TPS ≥1%, Duration of Response (DOR), Number of Participants Who Experienced One or More Adverse Events (AEs), Number of Participants Who Discontinued Study Treatment Due to an AE, Change from Baseline in Global Health Status/Quality of Life (GHS/QoL) (Items 29, 30) on the European Organization for Research and Treatment of Cancer QoL Questionnaire-Core 30 (EORTC QLQ-C30), Change from Baseline in Dyspnea Score (Item 8) on the EORTC QLQ-C30, Change from Baseline in Cough Score (Item 31) on the European Organization for Research and Treatment of Cancer Quality of Life Lung Cancer-Specific Questionnaire (EORTC QLQ-LC13), Change from Baseline in Chest Pain Score (Item 40) on the EORTC QLQ-LC13, Time to Deterioration (TTD) in GHS/QoL (Items 29, 30) on the EORTC QLQ-C30, TTD in Dyspnea Score (Item 8) on the EORTC QLQ-C30, TTD in Cough Score (Item 31) on the EORTC QLQ-LC13, TTD in Chest Pain Score (Item 40) on the EORTC QLQ-LC13

Source: https://euclinicaltrials.eu/ctis-public/view/2024-514500-14-00